EU clinical trial 2023-506781-30-00: I3Y-MC-JPBL: MONARCH 2: A Randomized, Double-Blind, Placebo-Controlled, Phase 3 Study of Fulvestrant with or without abemaciclib, a CDK4/6 Inhibitor, for Women with Hormone Receptor Positive, HER2 Negative Locally Advanced or Metastatic Breast Cancer
Protocol code: I3Y-MC-JPBL
Sponsor: Eli Lilly & Co. (Pharmaceutical company). Phase: Therapeutic confirmatory (Phase III). Countries: Belgium (ongoing, recruitment ended), Poland (ongoing, recruitment ended), Italy (ongoing, recruitment ended), Spain (ongoing, recruitment ended), Greece (ended).
Therapeutic area(s): Diseases [C] - Neoplasms [C04]
Gender: Female. Age: 18-64 years, 65+ years. Enrolment: 24.
Start date (EU): 2014-09-17. Decision date: 2024-05-17. Results received: No. Last updated: 2026-01-07.
Decision dates by country: GR: 2024-07-30, ES: 2024-05-17, BE: 2024-05-22, IT: 2024-05-24, PL: 2024-05-31

Condition(s): Breast cancer
Product: ABEMACICLIB, FULVESTRANT

Primary endpoint: Progression-Free Survival (PFS)

Source: https://euclinicaltrials.eu/ctis-public/view/2023-506781-30-00